EU clinical trial 2024-520098-12-00: A Multicenter, Randomized, Double-Blind, Placebo-Controlled, Phase 2a Study With an Open-Label Extension Evaluating the Efficacy and Safety of VENT-03 in Adult Participants With Active Cutaneous Lupus Erythematosus With or Without Systemic Lupus Erythematosus
Protocol code: VENT-03-201
Sponsor: Ventus Therapeutics U.S. Inc. (Pharmaceutical company). Phase: Therapeutic exploratory (Phase II). Countries: Poland (ongoing, recruiting), Czechia (ended), France (ongoing, recruiting), Bulgaria (ongoing, recruiting), Spain (ongoing, recruiting), Hungary (ongoing, recruiting).
Therapeutic area(s): Diseases [C] - Immune System Diseases [C20]
Gender: Female, Male. Age: 18-64 years, 65+ years. Enrolment: 13.
Start date (EU): 2026-02-16. Decision date: 2025-08-26. Results received: No. Last updated: 2026-06-12.
Decision dates by country: CZ: 2025-08-26, PL: 2025-09-01, FR: 2025-08-27, BG: 2025-08-28, HU: 2025-08-28, ES: 2025-08-28

Condition(s): Cutaneous Lupus Erythematosus
Product: Placebo tablets are composed of excipients found in VENT-03 tablets. Placebo tablets are identical to VENT-03 tablets., VENT-03

Primary endpoint: Percent change from baseline in the IFN gene signature in the skin at Day 28
Endpoint(s): Treatment-emergent adverse events (TEAEs), vital signs, electrocardiogram (ECG), physical examination, and safety laboratory assessments Change from baseline in MXA immunostaining in lesional skin biopsy Plasma concentrations and PK parameters of VENT-03

Source: https://euclinicaltrials.eu/ctis-public/view/2024-520098-12-00